EU clinical trial 2024-520149-22-00: mRNA Therapy to restore lymphatic flow in secondary lymphedema
Protocol code: RC31/24/0593
Sponsor: Centre Hospitalier Universitaire De Toulouse (Hospital/Clinic/Other health care facility). Phase: Phase I and Phase II (Integrated)- First administration to humans. Countries: France (authorised, recruitment pending).
Therapeutic area(s): Diseases [C] - Hemic and Lymphatic Diseases [C15]
Gender: Female. Age: 18-64 years, 65+ years. Enrolment: 9.
Status: Authorised, recruitment pending. Decision date: 2026-05-18. Results received: No. Last updated: 2026-07-10.

Condition(s): Lymphedema

Source: https://euclinicaltrials.eu/ctis-public/view/2024-520149-22-00